EU clinical trial 2024-517436-22-00: A Phase 2 Study of the Safety, Efficacy, and Pharmacodynamics of RTA 408 in the Treatment of Friedreich's Ataxia (MOXIe)
Protocol code: 408-C-1402
Sponsor: Reata Pharmaceuticals Inc. (Pharmaceutical company). Phase: Therapeutic exploratory (Phase II). Countries: Austria (ended), Italy (ended).
Therapeutic area(s): Diseases [C] - Nervous System Diseases [C10]
Gender: Female, Male. Age: 0-17 years, 18-64 years. Enrolment: 21.
Status: Ended. Start date (EU): 2016-07-21. End date (EU): 2025-06-11. End date: 2025-12-19. Decision date: 2024-11-15. Results received: Yes. Last updated: 2024-12-05.
Decision dates by country: IT: 2024-11-20, AT: 2024-12-05

Condition(s): Friedreich's ataxia
Product: RTA 408 Capsule, 10 mg, Skyclarys 50 mg hard capsules, RTA 408 Capsule, 2.5 mg, Skyclarys 50 mg hard capsules

Primary endpoint: Part 1: To evaluate the change in peak work during maximal exercise testing, Part 1: To evaluate the safety and tolerability of RTA 408, Part 2: To evaluate the change in the mFARS score at Week 48, Part 2: To evaluate the safety and tolerability of RTA 408
Endpoint(s): Part 1: To evaluate the change in the modified Friedreich’s ataxia rating scale (mFARS) score, Part 2: To evaluate the change in peak work during maximal exercise testing at Week 48, Part 2: To evaluate the Patient Global Impression of Change at Week 48, Part 2: To evaluate the Clinical Global Impression of Change at Week 48

Source: https://euclinicaltrials.eu/ctis-public/view/2024-517436-22-00